EU clinical trial 2023-508615-24-00: ENCORAFENIB+CETUXIMAB BEYOND PROGRESSION IN COMBINATION WITH FOLFIRI IN PATIENTS WITH BRAF V600E MUTATED METASTATIC COLORECTAL CANCER PROGRESSING ON ENCORAFENIB + CETUXIMAB
Protocol code: ECLYPse
Sponsor: Fondazione Policlinico Universitario Agostino Gemelli IRCCS (Hospital/Clinic/Other health care facility). Phase: Therapeutic exploratory (Phase II). Countries: Italy (ongoing, recruitment ended).
Therapeutic area(s): Diseases [C] - Neoplasms [C04]
Gender: Female, Male. Age: 18-64 years, 65+ years. Enrolment: 25.
Status: Ongoing, recruitment ended. Start date (EU): 2024-06-03. Decision date: 2024-04-04. Results received: No. Last updated: 2024-04-04.

Condition(s): Patients affected by mCRC harbouring BRAF V600E
Product: IRINOTECAN, FLUOROURACIL, CETUXIMAB, ENCORAFENIB, SODIUM FOLINATE

Primary endpoint: investigator-assessed 6-month progression-free survival (PFS) rate, defined as the proportion of patients alive and progression-free by the 6-month time point from start of investigational treatment. PFS is defined as the time elapsed between start of investigational treatment and the date of first event. The time-point for PFS is 6 months. Tumor assessment with CT scan of chest and abdomen will performed every 8 weeks from enrollment until evidence of disease progression or death
Endpoint(s): PFS (time elapsed from start of investigational treatment to the documentation of disease progression, according to RECIST 1.1, or death due to any cause, whichever occur first), OS (time elapsed from start of investigational treatment to the date of death due to any cause), DOR (time from response, in patients achieving CR or PR, to disease progression or death) Patients not experiencing disease progression or death will be censored at the date of the last follow-up visit., ORR (percentage of patients who achieve PR or CR as measured by RECIST 1.1 criteria), DCR (percentage of patients who achieve PR, CR or SD as measured by RECIST 1.1 criteria), Toxicity (rate of adverse events graded according to NCI-CTCAE version 4.03)

Source: https://euclinicaltrials.eu/ctis-public/view/2023-508615-24-00